EU clinical trial 2023-508322-10-00: A Double-Blind, Placebo-Controlled, Crossover Pilot Study of the Efficacy and Safety of Fluasterone Buccal Tablet in the Control of Hyperglycemia in Adults with Endogenous Cushing’s Syndrome
Protocol code: ST002-51
Sponsor: Sterotherapeutics LLC (Pharmaceutical company). Phase: Therapeutic exploratory (Phase II). Countries: Greece (ongoing, recruiting).
Therapeutic area(s): Diseases [C] - Hormonal diseases [C19]
Gender: Female, Male. Age: 18-64 years, 65+ years. Enrolment: 24.
Status: Ongoing, recruiting. Start date (EU): 2025-05-02. Decision date: 2024-03-26. Results received: No. Last updated: 2026-06-09.

Condition(s): Cushing Syndrome
Product: Placebo Buccal Tablets, Fluasterone Buccal Tablet

Primary endpoint: The primary efficacy endpoint is the change in area under the curve for glucose (AUCglucose) based on the 2-hour oGTT at week 12 versus baseline during each of the 12-week treatment periods.
Endpoint(s): The change in AUCglucose based on the 2-hour oGTT at week 6 versus baseline during each of the 12-week treatment periods., The change in HbA1c at weeks 6 and 12 versus baseline during each of the 12-week treatment periods, The change in serum lipid profiles at weeks 6 and 12 versus baseline during each of the 12-week treatment periods, The change in body habitus as evaluated by DEXA scanning at weeks 6 and 12 versus baseline during each of the 12-week treatment periods, The change in hepatic steatosis/fibrosis as evaluated by TEand MRI-PDFF at week 12 versus baseline during each of the 12-week treatment periods.

Source: https://euclinicaltrials.eu/ctis-public/view/2023-508322-10-00